EU clinical trial 2023-509909-74-00: An Open-label, Single Arm Study to Evaluate the Safety and Tolerability of Intravenous Difelikefalin in Adolescents Aged 12 to 17 Years on Haemodialysis with Moderate-to-Severe Pruritus (KOR-PED-202)
Protocol code: KOR-PED-202
Sponsor: Vifor Fresenius Medical Care Renal Pharma Ltd. (Pharmaceutical company). Phase: Therapeutic exploratory (Phase II). Countries: Spain (ongoing, recruiting), Greece (authorised, recruiting), Italy (authorised, recruitment pending), Portugal (authorised, recruitment pending).
Therapeutic area(s): Diseases [C] - Skin and Connective Tissue Diseases [C17]; Diseases [C] - Female Urogenital Diseases and Pregnancy Complications [C13]; Diseases [C] - Male Urogenital Diseases [C12]
Gender: Female, Male. Age: 0-17 years. Enrolment: 7.
Start date (EU): 2025-08-13. Decision date: 2025-03-31. Results received: No. Last updated: 2026-05-25.
Decision dates by country: IT: 2025-07-24, ES: 2025-03-31, PT: 2025-09-23, GR: 2025-04-02

Condition(s): Pruritus, Chronic Kidney Diseases
Product: Kapruvia 50 micrograms/mL solution for injection

Primary endpoint: Incidence of AEs.
Endpoint(s): Pre-dose difelikefalin plasma concentrations (Cpre), Trough difelikefalin plasma concentrations (Ctrough), Maximum difelikefalin plasma concentrations (Cmax)

Source: https://euclinicaltrials.eu/ctis-public/view/2023-509909-74-00